EU clinical trial 2024-520123-83-01: A phase-2 academic trial testing, in two parallel non-randomized cohorts, the combination of ruxolitinib (JAK1/2 inhibitor) with brentuximab or pembrolizumab in relapsed or refractory classical Hodgkin lymphoma (cHL)
Protocol code: cHL-PG01
Sponsor: Universita' Degli Studi Di Perugia (Educational Institution). Phase: Therapeutic exploratory (Phase II). Countries: Italy (ongoing, recruitment ended).
Therapeutic area(s): Diseases [C] - Neoplasms [C04]
Gender: Female, Male. Age: 18-64 years, 65+ years. Enrolment: 48.
Status: Ongoing, recruitment ended. Start date (EU): 2020-02-11. Decision date: 2025-01-31. Results received: No. Last updated: 2026-01-23.

Condition(s): Patients with relapsed or refractory cHL that has not responded to, or has progressed after, the previous treatment. Neither Cohort-1 nor Cohort-2 are open to patients with a partial response after the immediate prior treatment (including salvage therapy before autologous or allogeneic transplantation); such patients would become eligible only upon subsequent progression.
Product: ADCETRIS 50 mg powder for concentrate for solution for infusion., Jakavi 20 mg tablets, KEYTRUDA 25 mg/mL concentrate for solution for infusion

Primary endpoint: The primary endpoint in each cohort is to meet or exceed, according to a perprotocol analysis, a pre-determined rate of CR during, or at the end of, ruxolitinib treatment (i.e., obtained either at the interim disease evaluation during ruxolitinib treatment or at the end of ruxolitinib treatment, in comparison to the baseline disease status). The rate of CR has been set at ≥40% in both Cohorts to improve on the historical CR rates, in rela
Endpoint(s): To describe the type, incidence, grade and relationship to the study drugs of adverse events (AE) occurring in each cohort., To determine the rates of partial response (PR) and stable disease (SD) observed during ruxolitinib treatment and/or at the end of ruxolitinib treatment., To determine the rate of CR, PR and SD observed while patients are offruxolitinib and may continue brentuximab (Cohort-1) or pembrolizumab (Cohort- 2) on study., To assess the rate of successful hematopoietic stem cell harvesting and bridging to transplantation in both cohorts., To assess the specific type, efficacy and toxicity of subsequent treatments that the patients might receive after those planned in the current study, To assess the survival of patients: Progression-free survival, i.e. from start of treatment until date of progression; Overall survival, i.e. from start of treatment until death from any cause; Disease-specific survival, i.e. from start of treatment until death due to the disease or to its treatment; Treatment-free survival, i.e. from the end of study treatment until the beginning of a new treatment, To identify potential biomarkers of response through centralized analysis (at the Sponsor institution) of: Genetic and protein studies on archival and/or newly performed biopsies (e.g., genetic lesions of JAK-STAT pathway members; expression of PDL1, MHC-II, MHC-I and phosphorylated STAT transcription factors); Genetic and chemokine (e.g., TARC) studies on liquid biopsies taken before, during and after the study treatments.

Source: https://euclinicaltrials.eu/ctis-public/view/2024-520123-83-01